EU clinical trial 2023-509835-26-00: A Phase 2a, Randomized, Placebo-controlled, Dose-Ranging Study to Evaluate the Safety and Efficacy of PTC518 in Subjects with Huntington’s Disease
Protocol code: PTC518-CNS-002-HD
Sponsor: PTC Therapeutics Inc. (Pharmaceutical company). Phase: Therapeutic exploratory (Phase II). Countries: Germany (ended), Spain (ended), Italy (ended), Austria (ended), Netherlands (ended), France (ended).
Therapeutic area(s): Diseases [C] - Congenital, Hereditary, and Neonatal Diseases and Abnormalities [C16]
Gender: Female, Male. Age: 18-64 years, 65+ years. Enrolment: 121.
Status: Ended. Start date (EU): 2022-07-06. End date (EU): 2025-05-23. End date: 2025-07-29. Decision date: 2024-05-06. Results received: Yes. Last updated: 2025-06-20.
Decision dates by country: AT: 2024-05-10, FR: 2024-05-14, DE: 2024-05-07, IT: 2024-05-13, ES: 2024-05-06, NL: 2024-05-06

Condition(s): Huntington’s Disease
Product: Placebo to match 5-mg PTC518 tablets, Placebo to match 20-mg PTC518 tablets, PTC518, PTC518

Primary endpoint: Safety Endpoints: Safety profile as characterized by treatment-emergent adverse events (TEAEs), laboratory abnormalities, [CCI], electrocardiogram (ECG), vital signs, [CCI], [CCI], Columbia Suicide Severity Rating Scale (C SSRS), and physical examination, Primary Efficacy Endpoint: Change from Baseline in blood tHTT protein at Month 3
Endpoint(s): Change from Baseline in caudate volume as assessed via vMRI at Month 12 (key secondary), Change from Baseline in cUHDRS scores at Month 12, Change from Baseline in blood tHTT protein at Month 12, Change from Baseline in CSF mHTT protein at Month 12, Change from Baseline in blood mHTT protein at Month 12

Source: https://euclinicaltrials.eu/ctis-public/view/2023-509835-26-00